EU clinical trial 2024-513031-24-00: A Multicenter, Randomized, Double-blind, Placebo-controlled, Phase 3 Study Evaluating the Efficacy and Safety of Subcutaneous Anifrolumab in Adult Patients with Systemic Lupus Erythematosus
Protocol code: D3465C00001
Sponsor: AstraZeneca AB (Pharmaceutical company). Phase: Phase II and Phase III (Integrated). Countries: Hungary (ongoing, recruitment ended), Spain (ongoing, recruitment ended), Bulgaria (ongoing, recruitment ended), Germany (ongoing, recruitment ended), Poland (ongoing, recruitment ended).
Therapeutic area(s): Diseases [C] - Immune System Diseases [C20]
Gender: Female, Male. Age: 18-64 years, 65+ years. Enrolment: 96.
Status: Ongoing, recruitment ended. Start date (EU): 2021-10-22. Decision date: 2024-05-06. Results received: No. Last updated: 2026-06-18.
Decision dates by country: ES: 2024-05-06, DE: 2024-05-06, BG: 2024-05-20, PL: 2024-05-13, HU: 2024-05-06

Condition(s): Moderate-to-severe Systemic Lupus Erythematosus (SLE)
Product: Anifrolumab

Primary endpoint: BICLA a composite binary response defined by meeting all criteria as per protocol page 25 and 52
Endpoint(s): Proportion of patients who are BICLA responders at Week 52 and have maintained low (or reduced) OSC use through Week 52 maintained low (or reduced) OSC use is defined as per protocol pages 26 and 52., The time from first dose of study intervention during the Double-Blind Study Period to first BICLA response sustained through Week 52, Time to flare through Week 52 where flare is defined as either 1 or more new BILAG-2004 A or 2 or more new BILAG 2004 B items compared to the previous visit

Source: https://euclinicaltrials.eu/ctis-public/view/2024-513031-24-00